EU clinical trial 2024-517759-11-00: Impact of early proactive therapeutic drug monitoring on the durability and efficacy of infliximab therapy in pediatric inflammatory bowel disease: a multicenter open-label randomized-control trial
Protocol code: EPIC Study
Sponsor: Istituto Di Ricovero E Cura A Carattere Scientifico Materno Infantile Burlo Garofolo (Hospital/Clinic/Other health care facility). Phase: Therapeutic use (Phase IV). Countries: Italy (authorised, recruitment pending).
Therapeutic area(s): Diseases [C] - Digestive System Diseases [C06]; Diseases [C] - Immune System Diseases [C20]
Gender: Female, Male. Age: 0-17 years. Enrolment: 86.
Status: Authorised, recruitment pending. Decision date: 2024-10-14. Results received: No. Last updated: 2025-03-24.

Condition(s): Inflammatory Bowel Disease
Product: INFLIXIMAB, INFLIXIMAB

Primary endpoint: The primary composite endpoint is the frequency of IFX discontinuation, due to treatment failure or adverse events, or need for treatment intensification due to non-response or LOR during the first year of treatment.
Endpoint(s): The cumulative probability of IFX discontinuation, The cumulative probability of LOR, Subtherapeutic IFX concentrations,, Occurrence of ATI, Occurrence of infusion reactions, Endoscopic remission at 54 weeks, Treatment response at the end of induction between 12-14 weeks, Clinical remission at week 14, Clinical and biochemical remission at week 14

Source: https://euclinicaltrials.eu/ctis-public/view/2024-517759-11-00